EU clinical trial 2023-507489-20-00: N=1-studies In Statin-intolerance; Objectifying Nocebo Effects (NISONE)
Sponsor: Erasmus Universitair Medisch Centrum Rotterdam (Erasmus MC) (Hospital/Clinic/Other health care facility). Phase: Therapeutic use (Phase IV). Countries: Netherlands (ongoing, recruiting).
Therapeutic area(s): Diseases [C] - Cardiovascular Diseases [C14]
Gender: Female, Male. Age: 18-64 years, 65+ years. Enrolment: 249.
Status: Ongoing, recruiting. Start date (EU): 2024-12-10. Decision date: 2024-06-28. Results received: No. Last updated: 2026-04-22.
Decision dates by country: NL: 2024-09-18

Condition(s): Statin-intolerance, High cardiovascular risk (previous cardiovascular disease or familial hypercholesterolemia)
Product: Placebo of rosuvastatin 10mg (tablet) as produced by Apotheek A15, Rosuvastatin tablet 10mg Apotheek A15

Primary endpoint: (self-reported) statin use 12 months after inclusion.

Source: https://euclinicaltrials.eu/ctis-public/view/2023-507489-20-00